EU clinical trial 2024-519135-41-00: Phase II, single-arm, open-label interventional clinical trial to evaluate the role of anthracycline infusion after radiotherapy (RT) in pediatric and young adult patients with glioblastoma (pGBM)
Protocol code: pGBM-WBRT/DOX2020
Sponsor: Azienda Ospedaliera Universitaria Meyer IRCCS (Hospital/Clinic/Other health care facility). Phase: Therapeutic exploratory (Phase II). Countries: Italy (ongoing, recruitment ended).
Therapeutic area(s): Diseases [C] - Neoplasms [C04]
Gender: Female, Male. Age: 0-17 years, 18-64 years. Enrolment: 20.
Status: Ongoing, recruitment ended. Start date (EU): 2022-06-21. Decision date: 2025-01-13. Results received: No. Last updated: 2026-07-28.

Condition(s): Glioblastoma
Product: TEMOZOLOMIDE, DOXORUBICIN

Primary endpoint: The primary safety endpoint is defined as: - Time to early discontinuation of the experimental treatment with Doxorubicin - Percentage of subjects with Serious Adverse Events (SAE) that lead to withdrawal from the study - Percentage of SAE - Mortality due to adverse events - Proportion of early discontinuation of the experimental treatment with Doxorubicin
Endpoint(s): Event-free survival (EFS) that is the time between the date of enrollment and the date of occurrence of one of the following events: disease progression, any new lesions, clinical deterioration due to the tumor; failure to return for evaluation following death or deterioration of conditions., Overall survival (OS) defined as the time between the date of enrollment and the date of death from any cause, Progression-free survival (PFS) defined as the time between the date of enrollment and the date of progression according to modified RANO criteria, Proportion of treatment responder (CR, complete responder; PR, partial responder; SD, stable disease; PD, disease progression) according to modified RANO criteria

Source: https://euclinicaltrials.eu/ctis-public/view/2024-519135-41-00